EU clinical trial 2024-518794-33-00: Treatment of Warthin's tumor: schlerotherapy and its natural course
Sponsor: HUS-Yhtymae (Hospital/Clinic/Other health care facility). Phase: Therapeutic use (Phase IV). Countries: Finland (authorised, recruitment pending).
Therapeutic area(s): Diseases [C] - Otorhinolaryngologic Diseases [C09]; Diseases [C] - Neoplasms [C04]
Gender: Female, Male. Age: 18-64 years, 65+ years. Enrolment: 100.
Status: Authorised, recruitment pending. Decision date: 2024-11-05. Results received: No. Last updated: 2024-11-05.

Condition(s): Warthin's tumor
Product: Bleomycin Baxter 15 000 KY injektio-/infuusiokuiva-aine, liuosta varten

Primary endpoint: Volume change and symptom chaneg 6 and 12 months after treatment intervention

Source: https://euclinicaltrials.eu/ctis-public/view/2024-518794-33-00